EU clinical trial 2023-503420-19-00: A prospective, randomized, double-blind, placebo-controlled, two-stage, multicenter study with an open-label extension period to investigate the efficacy and safety of NT 201 in the treatment of lower limb spasticity in children and adolescents with cerebral palsy
Protocol code: M602011072
Sponsor: Merz Pharmaceuticals GmbH (Pharmaceutical company). Phase: Therapeutic confirmatory (Phase III). Countries: Latvia (ended), Poland (ended).
Therapeutic area(s): Diseases [C] - Nervous System Diseases [C10]
Gender: Female, Male. Age: 0-17 years. Enrolment: 25.
Status: Ended. Start date (EU): 2022-10-12. End date (EU): 2025-03-04. End date: 2025-03-05. Decision date: 2024-05-06. Results received: Yes. Last updated: 2024-12-20.
Decision dates by country: LV: 2024-05-13, PL: 2024-05-06

Condition(s): Pediatric lower limb (LL) spasticity (SP) caused by cerebral palsy (CP)
Product: XEOMIN 200 V pulveris injekciju šķīduma pagatavošanai, Placebo to NT201, XEOMIN, 200 jednostek, proszek do sporządzania roztworu do wstrzykiwań

Primary endpoint: Change in derived modified Ashworth Scale (MAS) score of plantar flexors from baseline at control visits at week 4 and week 6
Endpoint(s): Response in derived MAS score of plantar flexors at control visits at week 4 or week 6 with response defined as improvement of at least 1 point on the derived MAS score as compared to study baseline, GICS-PF score at control visits at week 4 and week 6 by investigator, GAS T-score at control visits at week 4 and week 6

Source: https://euclinicaltrials.eu/ctis-public/view/2023-503420-19-00